EU clinical trial 2022-501361-44-00: A phase III, randomised, double-blind, multicentre study comparing the efficacy, safety, and immunogenicity of proposed tocilizumab biosimilar (DRL_Tocilizumab) with tocilizumab reference product (RoActemra®) administered by the subcutaneous route as an add-on to methotrexate in the treatment of patients with moderate to severe rheumatoid arthritis
Protocol code: TC-01-003
Sponsor: Dr. Reddy's Laboratories Limited (Pharmaceutical company). Phase: Therapeutic confirmatory (Phase III). Countries: Estonia (not authorised), Lithuania (not authorised), Bulgaria (not authorised), Hungary (not authorised), Czechia (not authorised), Romania (not authorised), Poland (not authorised).
Therapeutic area(s): Diseases [C] - Immune System Diseases [C20]
Gender: Female, Male. Age: 18-64 years, 65+ years. Enrolment: 357.
Status: Not authorised. Decision date: 2023-10-06. Results received: No. Last updated: 2023-10-09.
Decision dates by country: EE: 2023-10-09, BG: 2023-10-09, PL: 2023-10-09, RO: 2023-10-09, HU: 2023-10-09, CZ: 2023-10-09, LT: 2023-10-06

Condition(s): Adult patients of either gender with active moderate to severe rheumatoid arthritis (1987 revised ACR criteria; Arnett et al. 1987) of at least 6 months duration, with an inadequate response to cDMARDs and currently on treatment with stable doses of MTX for at least 8 weeks prior to randomisation will be eligible for the study. Up to 25% of patients might have also been previously exposed to bDMARDs. Patients with previous exposure to other cDMARD and bDMARD would enter the study after an adequate washout period. Patients previously exposed to JAK pathway inhibitors will not be allowed in the study.
Product: DRL_TC, RoActemra 162 mg solution for injection in pre-filled syringe.

Primary endpoint: The following parameters will be compared between patients treated with DRL_TC and RMP: Primary endpoint for EMA: • Change in DAS28-ESR from Baseline to Week 13 [Time Frame: Baseline; Week 13]
Endpoint(s): The following parameters will be compared between patients treated with DRL_TC and RMP:Efficacy: • Change from Baseline in DAS28-ESR [Time Frame: Baseline; Week 5; Week 9; Week 13 (for US FDA); Week 17; Week 21; and Week 25 (for EMA)], • Change from Baseline in DAS28-CRP [Time Frame: Baseline; Week 5; Week 9; Week 13; Week 17; Week 21; and Week 25] • Proportion of patients with ACR20/ 50/ 70 response [Time Frame: Week 5; Week 9; Week 13; Week 17; Week 21; and Week 25], • Time to EULAR moderate or good response [Time Frame: Week 5; Week 9; Week 13; Week 17; Week 21; and Week 25] • Proportion of patients reaching moderate or good EULAR response based on DAS28-ESR [Time Frame: Week 5; Week 9; Week 13; Week 17; Week 21; and Week 25], Safety: • Incidence of AEs and SAEs [Time Frame: Baseline till EOS; different study periods will be separately considered] • Incidence of AEs and SAEs during transition phase [Time Frame: Week 25; Week 33], • Incidences of anaphylactic reactions, hypersensitivity reactions, and injection site reactions [Time Frame: Baseline till EOS; different study periods will be separately considered] • Incidence of anaphylactic reactions, hypersensitivity reactions, and injection site reactions during transition phase [Time Frame: Week 25; Week 33], Immunogenicity: • Incidence of ADAs including NAb and ADA Titres [Time Frame: Baseline through scheduled time points till EOS; different study periods will be separately considered] • Incidence of ADAs including NAb and ADA Titres during transition phase [Time Frame: Week 25; Week 33], Pharmacokinetics: • Population pharmacokinetic parameters [Time Frame: Baseline through scheduled time points till EOS], Pharmacodynamics: • Change in PD endpoints from baseline to selected time points [Time Frame: Baseline through scheduled time points]

Source: https://euclinicaltrials.eu/ctis-public/view/2022-501361-44-00